EU clinical trial 2024-511971-13-00: An open label, non-randomized trial to evaluate the safety and efficacy of a single infusion of OTL-200 in patients with Late Juvenile (LJ) Metachromatic Leukodystrophy (MLD)
Protocol code: OTL-200-07
Sponsor: Orchard Therapeutics (Europe) Limited (Pharmaceutical company). Phase: Therapeutic confirmatory (Phase III). Countries: Italy (ongoing, recruitment ended).
Therapeutic area(s): Phenomena and Processes [G] - Genetic Phenomena [G05]
Gender: Female, Male. Age: 0-17 years. Enrolment: 6.
Status: Ongoing, recruitment ended. Start date (EU): 2020-09-11. Decision date: 2024-04-30. Results received: No. Last updated: 2025-07-25.

Condition(s): Metachromatic Leukodystrophy (MLD) is an autosomal recessive disorder caused by mutations
Product: Libmeldy 2-10 x 10^6 cells/mL dispersion for infusion

Primary endpoint: Co-primary pharmacodynamic efficacy endpoints: •Change in ARSA activity levels in CSF from baseline to 24 months post treatment. •Change in neuronal metabolite ratio NAA: Cr in white matter regions of interest of the brain from baseline to 24 months post-treatment.
Endpoint(s): Change in CSF ARSA, Change in neuronal metabolite ratio, Change in ARSA in PBMC, CD14+ & CD15+, Engraftment, VCN in BM & PBMC, Change in severity scale for brain MRI asses, Change in neurocog function, Full NCE, Change in GMFC-MLD, Change in NCV, Conditioning related toxicity/AEs, Non-conditioning AEs, Hem.reconstitution, Incidence of inf. related reactions, Incidence & titers of ARSA antibodies, Abn.clonal proliferation, Absence of RCL, site analysis findings, ELFC-MLD, Add Brain MRI analyses

Source: https://euclinicaltrials.eu/ctis-public/view/2024-511971-13-00